EU clinical trial 2024-513489-20-00: A Phase 3, multicenter, randomized, evaluator-blinded clinical trial to assess the safety and efficacy of Clobetasol propionate ophthalmic nanoemulsion, 0.05% compared to Prednisolone acetate, 1% in the treatment of inflammation after cataract surgery in pediatric population 0 to 3 years of age (CLOSE-3).
Protocol code: CLOBOF3-17IA03
Sponsor: Laboratorios Salvat S.A. (Pharmaceutical company). Phase: Therapeutic confirmatory (Phase III). Countries: Spain (ongoing, recruiting).
Therapeutic area(s): Diseases [C] - Eye Diseases [C11]
Gender: Female, Male. Age: 0-17 years. Enrolment: 60.
Status: Ongoing, recruiting. Start date (EU): 2022-11-21. Decision date: 2024-06-27. Results received: No. Last updated: 2026-02-24.

Condition(s): Inflammation and pain associated with ocular surgery
Product: Pred Forte 10 mg/ml colirio en suspensión, Clobetasol propionate ophthalmic nanoemulsion, 0.05%

Primary endpoint: Number, frequency, severity and relationship to IMP of adverse events (AEs) up to last study visit, Number, frequency, severity and relationship to IMP of Serious AE (SAEs) up to last study visit, Proportion of patients discontinuing the study due to AEs, Proportion of patients discontinuing the study due to lack of efficacy, Change from baseline to each study visit in intraocular pressure (IOP), Change from baseline to each study visit in visual acuity and physical and eye examination parameters
Endpoint(s): Percentage of patients with anterior chamber inflammation of grade 0 at Visit 2 (Day 8±2), Visit 3 (Day 15±2), Visit 4 (Day 29±2) and Visit 5 (Day 43±3)., Change from baseline to Visit 2 (Day 8±2), Visit 3 (Day 15±2), Visit 4 (Day 29±2) and Visit 5 (Day 43±3) in the proportion of patients with different grades of anterior chamber inflammation, Proportion of patients with Grade 1, Grade 2, Grade 3 and Grade 4 of anterior chamber inflammation at Visit 1 (Day 1), Visit 2 (Day 8±2), Visit 3 (Day 15±2), Visit 4 (Day 29±2) and Visit 5 (Day 43±3)., Frequency of different signs and symptoms of ocular inflammation at baseline, Visit 2 (Day 8±2), Visit 3 (Day 15±2), Visit 4 (Day 29±2) and Visit 5 (Day 43±3)., Change from baseline to Visit 2 (Day 8±2), Visit 3 (Day 15±2), Visit 4 (Day 29±2) and Visit 5 (Day 43±3) in the Face, Legs, Activity, Cry, Consolability (FLACC) Behavioral Scale Score

Source: https://euclinicaltrials.eu/ctis-public/view/2024-513489-20-00